EU clinical trial 2026-525780-41-00: Bioequivalence of Tramadol retard 200 mg Prolonged-Release Tablets in Healthy Subjects Under Fed Conditions
Protocol code: CFA-1049-1-25
Sponsor: Laboratorios Cinfa S.A. (Pharmaceutical company). Phase: Human Pharmacology (Phase I)- Bioequivalence Study. Countries: Czechia (ongoing, recruitment ended).
Therapeutic area(s): Diseases [C] - Nervous System Diseases [C10]
Gender: Female, Male. Age: 18-64 years. Enrolment: 36.
Status: Ongoing, recruitment ended. Start date (EU): 2026-06-22. Decision date: 2026-06-04. Results received: No. Last updated: 2026-06-04.

Condition(s): Not applicable (submitted trial is a bioavailability trial in healthy participants).

Source: https://euclinicaltrials.eu/ctis-public/view/2026-525780-41-00